EU clinical trial 2022-501068-16-00: Insulin Resistance and Statin Treatment in Renal Transplant Recipients and Patients with Chronic Kidney Disease
Protocol code: INSTA
Sponsor: Aarhus University Hospital (Hospital/Clinic/Other health care facility). Phase: Therapeutic exploratory (Phase II). Countries: Denmark (ended).
Therapeutic area(s): Diseases [C] - Nutritional and Metabolic Diseases [C18]
Gender: Female, Male. Age: 18-64 years, 65+ years. Enrolment: 30.
Status: Ended. Start date (EU): 2022-12-14. End date (EU): 2025-01-23. Decision date: 2022-09-26. Results received: Yes. Last updated: 2024-08-28.

Condition(s): Insulin resistance
Product: CARBOHYDRATES, POTASSIUM CHLORIDE, Pravastatin Sandoz 40 mg tabletter, INSULIN (HUMAN), Name: Placebotablet 8 mm. Content supplied in the document Placebo Cataloging Form RAP 8 mm.

Primary endpoint: Insulin sensitivity assessed by hyperinsulinemic euglycemic glucose clamp

Source: https://euclinicaltrials.eu/ctis-public/view/2022-501068-16-00